EU clinical trial 2024-516214-38-00: Venetoclax after TKI to target persisting stem cells in CML
Protocol code: VARIANT
Sponsor: Friedrich-Schiller-Universitaet Jena (Educational Institution). Phase: Therapeutic exploratory (Phase II). Countries: Germany (ended).
Therapeutic area(s): Diseases [C] - Hemic and Lymphatic Diseases [C15]
Gender: Female, Male. Age: 18-64 years, 65+ years. Enrolment: 10.
Status: Ended. Start date (EU): 2024-10-15. End date (EU): 2026-05-13. Decision date: 2024-10-15. Results received: No. Last updated: 2025-09-01.

Condition(s): Chronic Myeloid Leukemia
Product: VENETOCLAX

Primary endpoint: Reduction of BCR::ABL1 stem cells measured by quantitative genomic PCR in bone marrow after venetoclax administration

Source: https://euclinicaltrials.eu/ctis-public/view/2024-516214-38-00